EU clinical trial 2024-518266-27-00: A Phase 3, Double-blind, Randomized, Placebo-controlled, Parallel-group, Multicenter Study to Evaluate the Safety, Tolerability, and Efficacy of 2000 mg/kg of Trappsol® Cyclo™ (Hydroxypropyl-β-cyclodextrin) and Standard of Care Compared to Placebo and Standard of Care in Patients with Niemann-Pick Disease Type C1
Protocol code: CTD-TCNPC-301
Sponsor: Cyclo Therapeutics Inc. (Pharmaceutical company). Phase: Therapeutic confirmatory (Phase III). Countries: Italy (ongoing, recruitment ended), Poland (ongoing, recruitment ended), Germany (ongoing, recruitment ended), Spain (ongoing, recruitment ended).
Therapeutic area(s): Phenomena and Processes [G] - Genetic Phenomena [G05]
Gender: Female, Male. Age: 0-17 years, 18-64 years, 65+ years. Enrolment: 36.
Status: Ongoing, recruitment ended. Start date (EU): 2022-02-02. Decision date: 2024-11-08. Results received: No. Last updated: 2026-03-09.
Decision dates by country: PL: 2024-11-11, IT: 2024-11-18, ES: 2024-11-08, DE: 2024-11-12

Condition(s): Niemann Pick Disease Type C1
Product: Zavesca 100 mg hard capsules, Sodium chloride 0.45% solution for infusion, Sodium chloride 0.9% solution for infusion, Trappsol Cyclo

Primary endpoint: The primary endpoints as measured in study patients, regardless of region and country, but submitted as primary to the EU and RoW are: • Interim Analysis: Mean change in the 5D-NPC-SS composite score (Ambulation, Fine Motor, Speech, Swallow, and Cognition) from Baseline (Week 0) to 48 weeks, The primary endpoints as measured in study patients, regardless of region and country, but submitted as primary to the EU and RoW are:• Final Analysis: Mean change in the 5D-NPC-SS composite score (Ambulation, Fine Motor, Speech, Swallow, and Cognition) from Baseline (Week 0) to 96 weeks, The primary endpoints as measured in all study patients, regardless of country, but submitted as primary to US are: • Interim Analysis: Mean change in the 4D-NPC-SS (Ambulation, Fine Motor, Speech, and Swallow) composite score from Baseline (Week 0) to 48 weeks, The primary endpoints as measured in all study patients, regardless of country, but submitted as primary to US are:• Final Analysis: Mean change in the 4D-NPC-SS (Ambulation, Fine Motor, Speech, and Swallow) composite score from Baseline (Week 0) to 96 weeks
Endpoint(s): Mean change from Baseline in the SCAFI at 48 and 96 weeks, Mean change from Baseline in the Vineland-2 composite raw score, including the optional Motor Skills domain, at 48 and 96 weeks, Mean change from Baseline in the patient’s ability to swallow as assessed by the PAS, at 48 and 96 weeks (at select sites)

Source: https://euclinicaltrials.eu/ctis-public/view/2024-518266-27-00